EU clinical trial 2025-522674-36-00: N1T-MC-MALO: A Master Protocol for a Randomized, Controlled, Clinical Trial of Multiple Pharmacologic Agents in Adult Participants With Metabolic Dysfunction-Associated Steatotic Liver Disease Who Are at Increased Risk of Developing Major Adverse Liver Outcomes (SYNERGY-Outcomes); N1T-MC-TZ01 Tirzepatide in participants with high-risk MASLD; N1T-MC-RT01 Retatrutide in participants with high-risk MASLD
Protocol code: N1T-MC-MALO
Sponsor: Eli Lilly & Co. (Pharmaceutical company). Phase: Therapeutic confirmatory (Phase III). Countries: Czechia (ongoing, recruiting), France (ongoing, recruiting), Netherlands (authorised, recruitment pending), Bulgaria (authorised, recruitment pending), Norway (authorised, recruitment pending), Austria (ongoing, recruiting), Poland (ongoing, recruiting), Spain (ongoing, recruiting), Italy (ongoing, recruiting), Hungary (ongoing, recruiting), Germany (ongoing, recruiting), Romania (ongoing, recruiting), Sweden (authorised, recruitment pending), Portugal (authorised, recruitment pending), Belgium (ongoing, recruiting).
Therapeutic area(s): Diseases [C] - Nutritional and Metabolic Diseases [C18]
Gender: Female, Male. Age: 18-64 years, 65+ years. Enrolment: 505.
Start date (EU): 2026-03-24. Decision date: 2026-01-27. Results received: No. Last updated: 2026-05-08.
Decision dates by country: AT: 2026-02-07, BE: 2026-01-29, BG: 2026-02-04, HU: 2026-02-03, IT: 2026-02-04, PT: 2026-01-29, RO: 2026-02-09, SE: 2026-01-27, NO: 2026-02-05, DE: 2026-02-04, PL: 2026-02-08, NL: 2026-02-04, CZ: 2026-01-27, ES: 2026-01-29, FR: 2026-01-29

Condition(s): Metabolic Dysfunction-Associated Steatotic Liver Disease
Product: TIRZEPATIDE, TIRZEPATIDE, Retatrutide, Retatrutide, TIRZEPATIDE, TIRZEPATIDE, TIRZEPATIDE, Retatrutide, Retatrutide, TIRZEPATIDE, Placebo to match LY, Retatrutide, Placebo to match LY

Primary endpoint: Time to First Occurrence of Any Component of the Composite Endpoint for Major Adverse Liver Outcomes (MALO), Composite endpoint comprised of progression to cirrhosis, development of large esophageal varices, gastric varices or development of varices needing treatment, development of ascites, development of hepatic encephalopathy, evidence of active or recent variceal hemorrhage, increase in model for end-stage liver disease (MELD) from ≤12 to ≥15, liver transplantation, all-cause mortality, [Time Frame: Baseline up to Study Completion (about 224 weeks)]

Source: https://euclinicaltrials.eu/ctis-public/view/2025-522674-36-00